EU clinical trial 2022-502052-30-00: A Phase III, Randomized, Double-Blind, Placebo-Controlled Study of Atezolizumab with or without Tiragolumab (Anti-Tigit Antibody) in Patients with Unresectable Esophageal Squamous Cell Carcinoma whose Cancers have not Progressed following Definitive Concurrent Chemoradiotherapy
Protocol code: YO42137
Sponsor: F. Hoffmann-La Roche AG (Pharmaceutical company). Phase: Therapeutic confirmatory (Phase III). Countries: Belgium (ended), Spain (ended), Austria (ended), Greece (ended), Poland (ended), Portugal (ended), Italy (ended), France (ended), Germany (ended).
Therapeutic area(s): Diseases [C] - Neoplasms [C04]
Gender: Female, Male. Age: 18-64 years, 65+ years. Enrolment: 167.
Status: Ended. Start date (EU): 2020-10-27. End date (EU): 2026-07-02. End date: 2026-07-22. Decision date: 2024-07-19. Results received: No. Last updated: 2026-06-12.
Decision dates by country: BE: 2024-07-19, DE: 2024-07-23, GR: 2024-09-25, IT: 2024-07-31, PT: 2024-07-19, PL: 2024-07-29, FR: 2024-07-22, AT: 2024-07-23, ES: 2024-07-23

Condition(s): Unresectable Esophageal Squamous Cell Carcinoma
Product: Tiragolumab, Tiragolumab Placebo, Tecentriq Placebo, Tecentriq 1 200 mg concentrate for solution for infusion

Primary endpoint: 1. Progression-Free Survival as determined by the investigator (for tiragolumab + atezolizumab compared with double placebo), 2. Overall survival (for tiragolumab + atezolizumab compared with double placebo), 3. Overall Survival (for placebo + atezolizumab compared with double placebo)
Endpoint(s): 1. Progression-Free Survival as determined by the investigator (for placebo + atezolizumab compared with double placebo), 2. Progression-Free Survival as determined by the investigator (for tiragolumab + atezolizumab compared with placebo + atezolizumab), 3. Overall Survival (for tiragolumab + atezolizumab compared with placebo + atezolizumab), 4. Progression-Free Survival as determined by the independent review facility (IRF) (for tiragolumab + atezolizumab compared with placebo + atezolizumab and double placebo), 5. Confirmed ORR as determined by the investigator (for tiragolumab + atezolizumab compared with placebo + atezolizumab and double placebo), 6. Confirmed ORR as determined by an IRF, 7. Duration of response as determined by the investigator, 8. Duration of response as determined by the IRF, 9. Proportion of patients with clinically meaningful changes in physical functioning, role functioning, global health status/quality of life, and dysphagia, as measured by the respective scales of the European Organisation for Research and Treatment of Cancer Quality of Life-Core 30 Questionnaire and the European Organisation for Research and Treatment of Cancer Quality of Life-Esophageal Cancer, Module 18 Questionnaire, 10. Incidence and severity of adverse events, 11. Severity for all events will be graded according to NCI CTCAE v5.0, and severity for CRS will also be graded according to the ASTCT consensus grading scale., 12. Serum concentration of tiragolumab and atezolizumab at specified timepoints, 13. Prevalence of anti-drug antibody (ADAs) to tiragolumab at baseline and incidence of ADAs to tiragolumab during the study, 14. Prevalence of ADAs to atezolizumab at baseline and incidence of ADAs to atezolizumab during the study

Source: https://euclinicaltrials.eu/ctis-public/view/2022-502052-30-00